EU clinical trial 2024-519813-74-00: A phase 1, double-blind, placebo-controlled, randomized, single ascending dose and multiple ascending dose study to assess the safety, tolerability, and pharmacokinetics of GHF-201 in healthy adult volunteers
Protocol code: CGH24001
Sponsor: CCDRD Cooperative Clinical Drug Research and Development AG, GHF-Golden Heart Flower Ltd. (Pharmaceutical company). Phase: Human Pharmacology (Phase I)- Other. Countries: Bulgaria (ended).
Therapeutic area(s): Diseases [C] - Congenital, Hereditary, and Neonatal Diseases and Abnormalities [C16]
Gender: Female, Male. Age: 18-64 years, 65+ years. Enrolment: 32.
Status: Ended. Start date (EU): 2025-06-27. End date (EU): 2026-01-19. Decision date: 2025-04-17. Results received: No. Last updated: 2025-04-17.

Condition(s): Adult polyglucosan body disease (APBD).

Source: https://euclinicaltrials.eu/ctis-public/view/2024-519813-74-00